EU clinical trial 2024-517398-26-01: Evaluation of intra articular Tranexamic acid for reduction of total blood loss in total hip arthroplasty
Sponsor: Region Hovedstaden (Hospital/Clinic/Other health care facility). Phase: Therapeutic exploratory (Phase II). Countries: Denmark (ongoing, recruiting).
Therapeutic area(s): Analytical,Diagnostic,Therapeutic Techniques and Equipment [E]-Surgical Procedures, Operative [E04]
Gender: Female, Male. Age: 18-64 years, 65+ years. Enrolment: 100.
Status: Ongoing, recruiting. Start date (EU): 2022-10-18. Decision date: 2024-11-15. Results received: No. Last updated: 2025-12-11.

Condition(s): Osteoarthritis
Product: Tranexamic Acid 100 mg/ml Solution for Injection

Primary endpoint: Total blood loss 24 hours after the operation
Endpoint(s): Total blood loss on the morning af the 2nd postoperative day.

Source: https://euclinicaltrials.eu/ctis-public/view/2024-517398-26-01